EU clinical trial 2023-508670-28-00: MLS-101-901: An Open-Label Extension Study to Assess the Long-Term Safety, Efficacy, and Tolerability of Lorundrostat in Subjects with Hypertension
Protocol code: MLS-101-901
Sponsor: Mineralys Therapeutics Inc. (Pharmaceutical company). Phase: Therapeutic confirmatory (Phase III). Countries: Germany (ongoing, recruitment ended), Netherlands (ongoing, recruitment ended), Bulgaria (ongoing, recruitment ended), Italy (ongoing, recruitment ended), Romania (ongoing, recruitment ended), France (ongoing, recruitment ended), Spain (ongoing, recruitment ended), Poland (ongoing, recruitment ended).
Therapeutic area(s): Diseases [C] - Cardiovascular Diseases [C14]
Gender: Female, Male. Age: 18-64 years, 65+ years. Enrolment: 370.
Status: Ongoing, recruitment ended. Start date (EU): 2024-08-26. Decision date: 2024-08-14. Results received: No. Last updated: 2026-07-16.
Decision dates by country: RO: 2024-08-20, FR: 2024-08-20, ES: 2024-08-14, BG: 2024-08-16, DE: 2024-08-15, NL: 2024-08-19, PL: 2024-08-21, IT: 2024-08-19

Condition(s): Hypertension
Product: Lorundrostat, Synacthen 0,25 mg/ml Injektionslösung, Lorundrostat Placebo tablet, Lorundrostat, Lorundrostat

Primary endpoint: Change from MLS-101-301 baseline automated office blood pressure (AOBP) SBP at MLS-101-901 Week 36 in subjects who were enrolled in the lorundrostat arms of MLS-101-301 and were not assigned to the placebo arm of the MLS-101-901 RTW substudy (Objective: To assess the long-term maintenance of the AHT effect of lorundrostat in subjects with hypertension), Change at MLS-101-901 Week 16 (RTW Week 4) from MLS-101-901 Week 12 (RTW substudy baseline) in AOBP SBP in subjects enrolled in RWT study(Objective: To assess the efficacy of lorundrostat in subjects with hypertension by conducting a double- blind, randomized treatment withdrawal (RTW) substudy), Change from baseline to week 12 in AOBP SBP in various groups from the subjects from the parent studies (Objective: To explore the efficacy of lorundrostat at a starting dose of 25 mg QD in subjects with hypertension), Change from baseline to week 12 AOBP in subjects from various groups of the parent studies(Objective: To explore the efficacy of lorundrostat at a starting dose of 25 mg QD in subjects with hypertension), Change from MLS-101-901 baseline AOBP SBP at MLS101-901 Week 12 in subjects who were enrolled in the placebo arm of MLS-101-301 (Objective: To explore the efficacy of lorundrostat in improving BP in subjects with hypertension), Percent change in urine albumin creatinine ratio (UACR) from MLS 101 901 baseline by visit in the periods of exposure to lorundrostat during MLS-101-901 for subjects with albuminuria at the parent study baseline (Objective: To explore the efficacy of lorundrostat in improving albuminuria)

Source: https://euclinicaltrials.eu/ctis-public/view/2023-508670-28-00